EU clinical trial 2023-509277-22-00: Inhaled ColiFin® in adult bronchiectasis patients with new asymptomatic Pseudomonas aeruginosa infection – an open-label, proof of concept - randomized controlled trial (DZL-Eradicate)
Protocol code: KKS-287
Sponsor: Philipps-Universitaet Marburg (Educational Institution). Phase: Therapeutic exploratory (Phase II). Countries: Germany (ongoing, recruiting).
Therapeutic area(s): Diseases [C] - Respiratory Tract Diseases [C08]
Gender: Female, Male. Age: 18-64 years, 65+ years. Enrolment: 66.
Status: Ongoing, recruiting. Start date (EU): 2022-06-22. Decision date: 2024-09-17. Results received: No. Last updated: 2026-07-09.

Condition(s): Bronchiectasis
Product: ColiFin® 2 Millionen I.E. Pulver zur Herstellung einer Lösung für einen Vernebler

Primary endpoint: Proportion of sputum/airway culture negativity (=3 consecutively negative sputum/airway cultures) for PA 28 weeks after randomisation
Endpoint(s): Change in PA (semi-quantitative) in sputum from baseline to Day 29 of treatment, Rate of pulmonary exacerbations in 28 weeks after randomisation, Rate of severe exacerbations (hospitalizations) in 28 weeks after randomisation, Time to first pulmonary exacerbation after start of treatment, Change from baseline in respiratory symptom domain of the SGRQ ountil 28 weeks after randomization, Change from baseline in quality of life measured by SGRQ until 28 weeks after randomization, Change from baseline in quality of life measured by QOL-B until 28 weeks after randomization, Change from baseline on change in ppFEV1, Change in antibiotic susceptibility in isolated sputum PA until 28 weeks after randomization

Source: https://euclinicaltrials.eu/ctis-public/view/2023-509277-22-00